EU clinical trial 2023-503587-17-00: A Phase 1/Phase 2 Clinical Study to Evaluate the Safety and Efficacy of a Combination of MK-4280 and Pembrolizumab (MK-3475) in Participants with Hematologic Malignancies
Protocol code: MK-4280-003
Sponsor: Merck Sharp & Dohme LLC (Pharmaceutical company). Phase: Phase I and Phase II (Integrated)- Other. Countries: Italy (ended), Germany (ended), Greece (ended), Hungary (ended).
Therapeutic area(s): Diseases [C] - Neoplasms [C04]
Gender: Female, Male. Age: 18-64 years, 65+ years. Enrolment: 35.
Status: Ended. Start date (EU): 2019-03-20. End date (EU): 2025-10-09. End date: 2026-01-28. Decision date: 2023-10-05. Results received: No. Last updated: 2025-09-18.
Decision dates by country: GR: 2024-08-28, HU: 2024-07-17, DE: 2023-10-05, IT: 2023-10-05

Condition(s): Hematologic malignancies
Product: KEYTRUDA 25 mg/mL concentrate for solution for infusion, favezelimab

Primary endpoint: Percentage of Participants Experiencing a Dose-limiting Toxicity (DLT), Percentage of Participants Experiencing an Adverse Event (AE), Percentage of Participants with Treatment Discontinuations Due to an AE
Endpoint(s): Objective Response Rate (ORR)

Source: https://euclinicaltrials.eu/ctis-public/view/2023-503587-17-00